EU clinical trial 2023-507187-39-00: A Phase 3, Open-Label, Multi-Center, Randomized Study Evaluating the Efficacy and Safety of TAR-200 in Combination with Cetrelimab or TAR-200 Alone Versus Intravesical Bacillus Calmette-Guérin (BCG) in Participants with BCG-naïve High-Risk Non-Muscle Invasive Bladder Cancer (HRNMIBC)
Protocol code: 17000139BLC3002
Sponsor: Janssen - Cilag International (Pharmaceutical company). Phase: Therapeutic confirmatory (Phase III). Countries: Germany (ongoing, recruitment ended), Spain (ongoing, recruitment ended), Czechia (ongoing, recruitment ended), Netherlands (ongoing, recruitment ended), Belgium (ongoing, recruitment ended), Portugal (ongoing, recruitment ended), Italy (ongoing, recruitment ended), Poland (ongoing, recruitment ended), France (ongoing, recruitment ended).
Therapeutic area(s): Diseases [C] - Neoplasms [C04]
Gender: Female, Male. Age: 18-64 years, 65+ years. Enrolment: 391.
Status: Ongoing, recruitment ended. Start date (EU): 2023-03-23. Decision date: 2024-04-05. Results received: No. Last updated: 2026-04-20.
Decision dates by country: BE: 2024-04-16, CZ: 2024-04-09, FR: 2024-04-05, IT: 2024-05-22, PT: 2024-04-10, ES: 2024-04-05, NL: 2024-04-05, DE: 2024-04-05, PL: 2024-04-24

Condition(s): High-Risk Non-muscle-invasive Bladder Cancer
Product: BCG VACCINE, JNJ-63723283, JNJ-17000139, JNJ-63723283

Primary endpoint: EFS will be measured as the time from randomization to either the time of the first recurrence of high-risk disease, progression, or death due to any cause, whichever occurs first. For participants with CIS, persistent disease at 6 months (Week 24) is also considered an EFS event. Progression is defined as: 1) an increase of stage from Ta to T1 or from CIS to T1, or 2) progression to MIBC (T≥2) or to lymph node (N+) or to distant disease (M+), whichever occurs first.

Source: https://euclinicaltrials.eu/ctis-public/view/2023-507187-39-00